EU clinical trial 2024-514610-13-00: ARGO Colchicine versus Placebo in Acute Myocarditis Patients to Reduce Late Gadolinium Enhancement Mass on Cardiac Magnetic Resonance and the risk of Clinical Outcomes: The ARGO trial
Protocol code: APHP211429
Sponsor: Assistance Publique Hopitaux De Paris (Hospital/Clinic/Other health care facility). Phase: Therapeutic confirmatory (Phase III). Countries: France (ongoing, recruiting).
Therapeutic area(s): Diseases [C] - Cardiovascular Diseases [C14]
Gender: Female, Male. Age: 18-64 years. Enrolment: 300.
Status: Ongoing, recruiting. Start date (EU): 2024-10-04. Decision date: 2024-10-04. Results received: No. Last updated: 2026-03-03.

Condition(s): patients suffering from acute myocarditis confirmed on Cardiac magnetic resonance imaging.
Product: PLACEBO DE COLCHICINE 1 mg, COLCHICINE OPOCALCIUM 1 mg, comprimé sécable

Primary endpoint: - Extent of late gadolinium enhancement (% of left ventricle mass) evaluated on CMR at 6 months. OR - Composite clinical outcome at 6 months, defined as the occurrence of heart Failure or acute myocarditis recurrence; or a clinically relevant chest pain (defined as leading to an unplanned/urgent consultation or hospitalization or requiring an additional treatment); or a sustained ventricular arrhythmia; left ventricular assistance; or heart transplantation; or cardiovascular death during the s
Endpoint(s): Rate of Serious Adverse Events related to colchicine at 6 months, rate of permanent discontinuation on 6 months, rate of diarrhea, rate of nausea and/or vomiting and rate of myelotoxicity on 6 months, renal function during hospitalization and at 6 months., Efficacy of colchicine between the two groups : a- Composite clinical outcome at 1 year b- Each component of the composite clinical endpoint at 6 months and 1 year, Rate of heart failure or recurrence of acute myocarditis, Rates of clinically relevant chest pain (defined as requiring unscheduled/urgent consultation or hospitalisation or additional treatment), Rate of sustained ventricular arrhythmias, Rate of left ventricular assistance, Rate of heart transplantation, Cardiovascular mortality rate, LVEF (Left Ventricular Ejection Fraction), GEDV (TeleDiastolic Volume) and TSV (TeleSystolic Volume) volumes determined on a 6-month cardiac MRI using Corelab centralised reading., Relative change in LVEF, LVOT and STV volumes, determined by follow-up transthoracic echocardiography at 6 months,, The relative change in late gadolinium enhancement and oedema determined on a 6-month follow-up cardiac MRI scan using Corelab centralised reading., Cardiac magnetic resonance criteria at 6 months: value of native T1 and T2 mapping (ms), percentage of extracellular volume., g/ Serum biomarkers during the hospitalization period (eg: admission, 24h, 48h (after admission), inclusion or discharge) and at 6 months: Troponin (I or T according to investigator), NT-pro BNP, CRP, CK, For centres participating in the bio-collection: specific inflammatory markers IL-6, ST2 and IL-1β at inclusion; 24 and 48 hours after inclusion if possible; and at 6 months (after randomisation, Burden of VSE (Ventricular ExtraSystoles) measured at 3 months on Holter ECG

Source: https://euclinicaltrials.eu/ctis-public/view/2024-514610-13-00